EU clinical trial 2022-503037-63-00: A two-part, open-label study to assess the pharmacokinetics, pharmacodynamics and safety of single doses of inhaled and intravenously administered D,L lysine acetylsalicylate • glycine (LASAG) in healthy adult subjects: Study Part A follows a randomized, cross-over design to compare three dose levels of inhaled LASAG to one dose level of intravenously administered LASAG and Study Part B follows a single group design to investigate a XXXXX LASAG inhalation solution.
Protocol code: ASPI-AAP-006-01
Sponsor: Aspiair GmbH (Pharmaceutical company). Phase: Human Pharmacology (Phase I)- Other. Countries: Germany (ended).
Therapeutic area(s): Diseases [C] - Nervous System Diseases [C10]; Diseases [C] - Pathological Conditions, Signs and Symptoms [C23]
Gender: Female, Male. Age: 18-64 years. Enrolment: 28.
Status: Ended. Start date (EU): 2023-08-17. End date (EU): 2024-02-21. Decision date: 2023-05-19. Results received: No. Last updated: 2024-02-01.

Condition(s): Phase I, Clinical trial in healthy males and females intended indication: migraine

Source: https://euclinicaltrials.eu/ctis-public/view/2022-503037-63-00